EU clinical trial 2025-524910-28-00: A bioequivalence study comparing Empagliflozin 25 mg film-coated tablets, VIANEX S.A., Greece versus Jardiance 25 mg film-coated tablets, Boehringer Ingelheim International GmbH, Germany, in healthy male and female volunteers under fasting conditions.
Sponsor: Vianex S.A. (Pharmaceutical company). Phase: Human Pharmacology (Phase I)- Bioequivalence Study. Countries: Czechia (ended).
Therapeutic area(s): Diseases [C] - Cardiovascular Diseases [C14]
Gender: Female, Male. Age: 18-64 years. Enrolment: 36.
Status: Ended. Start date (EU): 2026-03-09. End date (EU): 2026-03-24. Decision date: 2026-02-18. Results received: No. Last updated: 2026-02-18.

Condition(s): none - healthy volunteers

Source: https://euclinicaltrials.eu/ctis-public/view/2025-524910-28-00